EU clinical trial 2024-518098-33-01: LONGITUDINAL FOLLOW-UP OF SARS-COV-2 IMMUNITY IN IMMUNOCOMPROMISED POPULATIONS IN BELGIUM (COVICO) A non-commercial multicenter academic prospective cohort study during 2023-2026
Sponsor: Sciensano (Laboratory/Research/Testing facility). Phase: Therapeutic use (Phase IV). Countries: Belgium (authorised, recruitment pending).
Therapeutic area(s): Phenomena and Processes [G] - Immune system processes [G12]
Gender: Female, Male. Age: 18-64 years, 65+ years. Enrolment: 360.
Status: Authorised, recruitment pending. Decision date: 2024-11-25. Results received: No. Last updated: 2024-11-25.

Condition(s): Healthy persons and immunocompromised patients (nursing home residents, dialysis patients and kidney- and lung transplant patients) from age 18 till age 105
Product: Comirnaty Omicron XBB.1.5 30 micrograms/dose dispersion for injection COVID-19 mRNA Vaccine, Comirnaty JN.1 30 micrograms/dose dispersion for injection COVID-19 mRNA Vaccine

Primary endpoint: To assess the level of binding and neutralizing antibodies against the epidemiologically predominant SARS-CoV-2 variant of concern (VOC) three times a year
Endpoint(s): Secondary objectives include studying the vaccine induced immunity in more detail. This includes the further characterization of the quality of the antibody response and the measurement of the cellular immune response, amongst others.

Source: https://euclinicaltrials.eu/ctis-public/view/2024-518098-33-01